EU clinical trial 2023-507977-16-00: A Phase 2, Double-Blind, Randomized, Placebo-Controlled Study to Evaluate the Efficacy and Safety of Ravulizumab in Adult Participants With Proliferative Lupus Nephritis (LN) or Immunoglobulin A Nephropathy (IgAN)
Protocol code: ALXN1210-NEPH-202
Sponsor: Alexion Pharmaceuticals Inc. (Pharmaceutical company). Phase: Therapeutic exploratory (Phase II). Countries: Italy (ended), Poland (ended), Spain (ended), Sweden (ended), France (ended), Germany (ended), Netherlands (ended).
Therapeutic area(s): Diseases [C] - Immune System Diseases [C20]
Gender: Female, Male. Age: 18-64 years, 65+ years. Enrolment: 87.
Status: Ended. Start date (EU): 2021-05-10. End date (EU): 2025-07-15. End date: 2025-08-18. Decision date: 2024-03-11. Results received: Yes. Last updated: 2025-06-04.
Decision dates by country: NL: 2024-04-11, PL: 2024-03-20, DE: 2024-03-12, FR: 2024-03-15, SE: 2024-03-12, IT: 2024-03-15, ES: 2024-03-11

Condition(s): Lupus Nephritis (LN) Immunoglobulin A Nephropathy (IgAN)
Product: Ultomiris 300 mg/30 mL concentrate for solution for infusion, Concentrate for solution for infusion

Primary endpoint: Percentage change in proteinuria
Endpoint(s): Common to both disease cohorts: - Percentage change in proteinuria - Change from baseline in eGFR, For LN: - Percentage of participants meeting the criteria for Complete Renal Response - Percentage of participants meeting the criteria for Partial Renal Response - Time to UPCR (Urine Protein to Creatinine Ratio) < 0.5 g/g - Percentage of participants achieving corticosteroid taper to 7.5 mg/day - Percentage of participants with Renal Flare - Percentage of participants with Extrarenal SLE (Systemic Lupus Erythematosus) Flare, For IgAN: - Percentage of participants meeting the criteria for Partial Remission

Source: https://euclinicaltrials.eu/ctis-public/view/2023-507977-16-00